EU clinical trial 2024-517497-17-01: Can a one-off administration of psilocybin reduce alcohol intake in patients with alcohol use disorder? A randomized, double-blinded, placebo-controlled clinical trial.
Protocol code: PSILO4ALCO
Sponsor: Region Hovedstaden (Hospital/Clinic/Other health care facility). Phase: Phase I and Phase II (Integrated)- Other. Countries: Denmark (ongoing, recruiting).
Therapeutic area(s): Psychiatry and Psychology [F] - Mental Disorders [F03]
Gender: Female, Male. Age: 18-64 years, 65+ years. Enrolment: 100.
Status: Ongoing, recruiting. Start date (EU): 2023-09-01. Decision date: 2024-11-14. Results received: No. Last updated: 2026-01-13.

Condition(s): Alcohol Use Disorder
Product: PEX010 Psilocybin Capsules ( 25mg psilocybin)

Primary endpoint: Percentage of heavy drinking days during the last 28 days. A heavy drinking day is defined as a day with an excess intake of 60/48 grams (men/women) of alcohol per day. Data will be registered via TLFB.
Endpoint(s): Total alcohol consumption (gram/day) during the last 28 days. Data will be registered via TLFB., Percentage of days without any alcohol consumption during the last 28 days. Data will be registered via TLFB., Penn Alcohol Craving Scale (PACS) score., Alcohol Use Disorders Identification Test (AUDIT) score., Drug Use Disorders Identification Test (DUDIT) score., Alcohol Abstinence Self-efficacy (AASE) score., Quality of life (SF-36) score., Major Depression Inventory (MDI) score., Mindful Attention Awareness Scale (MAAS) score., NEO Personality Inventory score., Acceptance and Action Questionnaire score., Fagerström Test for Nicotine Dependence (FTND) score., Phosphatidyl-ethanol (PEth)., Liver parameters gamma-glutamyltransferase (GGT), alanine aminotransferase (ALAT) and mean corpuscular volume (MCV)., Brain-derived neurotrophic factor (BDNF)., Markers of inflammation (TNF-a and IL-6)., Pharmacokinetic properties of plasma psilocin., Key phenomena of the acute subjective experience assessed by questionnaires including the Mystical Experience Questionnaire (MEQ30), 11-Dimensional Altered State of Consciousness (11D-ASC)51, Emotional Breakthrough Inventory (EBI), Ego-dissolution Inventory (EDI), The Awe Experience Scale (AES) and the Experience of Music (EM) as well as qualitative analysis of video/audio recordings (before, during and after the psilocybin session)., Changes in emotional response to music as rated by the Geneva Emotional Music Scale (GEMS) and qualitative descriptions obtained by semi-structured interviews., Persisting Effects Questionnaire (PEQ) score, Post dosing fMRI analysis including differences in functional connectivity during resting state and task-related activity between treatment groups.

Source: https://euclinicaltrials.eu/ctis-public/view/2024-517497-17-01